EU clinical trial 2025-522753-19-02: Exploring the Psychoactive Effects of Paracetamol: A parallel group, basic science, double blind, two armed study, to investigate potential emotional and cognitive effects of paracetamol (tablet form) compared to a placebo (tablet form) in healthy male and female participants between ages 18 and 30.
Sponsor: Oslo Metropolitan University (Educational Institution). Phase: Therapeutic use (Phase IV). Countries: Norway (authorised, recruitment pending).
Therapeutic area(s): Psychiatry and Psychology [F] - Psychological Phenomena [F02]
Gender: Female, Male. Age: 18-64 years. Enrolment: 84.
Status: Authorised, recruitment pending. Decision date: 2026-01-27. Results received: No. Last updated: 2026-01-27.

Condition(s): Healthy adults aged 18-30.
Product: Paracetamol Norfri 500 mg filmdrasjerte tabletter., Placebo

Primary endpoint: • Self-reported negative affect as measured with PANAS over the intervention period.
Endpoint(s): To assess whether paracetamol affects neurophysiological functioning in general and specifically related to emotion processing and stress, and if paracetamol affects anxiety, stress, depression and insomnia symptoms over the study period., • Self-reported positive affect as measured with PANAS over the intervention period., Anxiety score (BAI-II) measured on the 7th day, Depression score (BDI-II) measured on the 7th day, Perceived stress scale (PSS score) measured on the 7th day, Sleep, measured by Pittsburg Sleep Scale (PSQ-I score) on the 7th day, EEG: LPP response to emotional stimuli measured in the Emotional Interrupt Task, EEG: Resting state EEG dynamics Self-reported and evoked physiological stress response in the Montreal Imaging Stress Task (MIST)., Biomarkers: Change of IL-6 and IL-8 during intervention period.

Source: https://euclinicaltrials.eu/ctis-public/view/2025-522753-19-02